EU clinical trial 2024-515128-35-00: An open-label dose escalation study to estimate maximum tolerated dose (MTD), identify dose-limiting toxicities (DLTs) and study pharmacokinetics following a single dose of intracranially administered temozolomide-based SI-053 as an add-on to the current standard of care (SoC), in adult patients with newly diagnosed glioblastoma (GBM).
Protocol code: DBP-053-01
Sponsor: Double Bond Pharmaceutical AB (Pharmaceutical company). Phase: Human Pharmacology (Phase I)- First administration to humans. Countries: Germany (authorised, recruitment pending), Netherlands (authorised, recruitment pending).
Therapeutic area(s): Diseases [C] - Neoplasms [C04]
Gender: Female, Male. Age: 18-64 years. Enrolment: 27.
Status: Authorised, recruitment pending. Decision date: 2024-09-11. Results received: No. Last updated: 2026-06-16.
Decision dates by country: DE: 2024-09-11, NL: 2024-09-11

Condition(s): Glioblastoma

Source: https://euclinicaltrials.eu/ctis-public/view/2024-515128-35-00